EU clinical trial 2023-506425-12-00: MLS-101-301: A Randomized, Double-Blind, Placebo Controlled, Parallel Arm, Multicenter Phase 3 Study to Evaluate the Efficacy and Safety of Lorundrostat in Subjects with Uncontrolled and Resistant Hypertension
Protocol code: MLS-101-301
Sponsor: Mineralys Therapeutics Inc. (Pharmaceutical company). Phase: Therapeutic confirmatory (Phase III). Countries: Poland (ended), France (ended), Spain (ended), Italy (ended), Netherlands (ended), Bulgaria (ended), Germany (ended), Romania (ended).
Therapeutic area(s): Diseases [C] - Cardiovascular Diseases [C14]
Gender: Female, Male. Age: 18-64 years, 65+ years. Enrolment: 420.
Status: Ended. Start date (EU): 2024-04-17. End date (EU): 2025-01-16. End date: 2025-01-25. Decision date: 2024-04-08. Results received: Yes. Last updated: 2025-01-24.
Decision dates by country: DE: 2024-04-25, RO: 2024-05-27, IT: 2024-04-10, FR: 2024-04-10, NL: 2024-04-11, ES: 2024-05-23, PL: 2024-04-12, BG: 2024-04-15

Condition(s): Uncontrolled and Resistant Hypertension
Product: Lorundrostat Placebo Tablets, Lorundrostat, Synacthen 0,25 mg/ml Injektionslösung, Lorundrostat

Primary endpoint: Change from baseline in automated office BP (AOBP) SBP at Week 6 in subjects randomized to lorundrostat 50 mg QD compared to subjects randomized to placebo
Endpoint(s): Proportion of subjects with AOBP SBP <130 mmHg at Week 6 in subjects randomized to lorundrostat 50 mg QD compared to subjects randomized to placebo, Change from baseline in AOBP SBP at Week 12 in subjects randomized to lorundrostat 50 mg QC with escalation to lorundrostat 100 mg QD compared to subjects randomized to placebo, Change from baseline in AOBP SBP at Week 6 in subjects with uncontrolled hypertension on 2 prescribed AHT medications randomized to lorundrostat 50 mg QD compared to subjects with uncontrolled hypertension on 2 prescribed AHT medications randomized to placebo, Change from baseline in AOBP SBP at Week 6 in subjects with uncontrolled hypertension on 3 or more prescribed AHT medications (resistant hypertension) randomized to lorundrostat 50 mg QD compared to subjects with uncontrolled hypertension on 3 or more prescribed AHT medications (resistant hypertension) randomized to placebo, Change from baseline in AOBP SBP at Week 6 by obesity status in in subjects randomized to lorundrostat 50 mg QD compared to subjects randomized to placebo, Change from baseline in AOBP SBP at Week 12 in subjects who were escalated to lorundrostat 100 mg QD at Week 6 (within-subjects analysis)

Source: https://euclinicaltrials.eu/ctis-public/view/2023-506425-12-00